EU clinical trial 2023-505292-73-00: A Phase 2a, Randomized, Double-Blind, Placebo-Controlled Study to Evaluate the Safety and Tolerability, Pharmacokinetics, Pharmacodynamics, and Preliminary Efficacy of the NOX1/4 Inhibitor Setanaxib in Patients with Alport Syndrome
Protocol code: GSN000500
Sponsor: Calliditas Therapeutics Suisse S.A. (Pharmaceutical company). Phase: Therapeutic exploratory (Phase II). Countries: Spain (ended), Czechia (ended), France (ended), Austria (ended), Lithuania (ended), Slovakia (ended).
Therapeutic area(s): Diseases [C] - Congenital, Hereditary, and Neonatal Diseases and Abnormalities [C16]
Gender: Female, Male. Age: 18-64 years. Enrolment: 28.
Status: Ended. Start date (EU): 2024-01-10. End date (EU): 2025-06-25. End date: 2025-06-26. Decision date: 2023-11-13. Results received: Yes. Last updated: 2025-03-14.
Decision dates by country: ES: 2023-11-13, CZ: 2023-11-21, FR: 2024-10-10, AT: 2024-11-04, LT: 2024-10-22, SK: 2024-10-21

Condition(s): Alport syndrome
Product: Setanaxib, Placebo tablets

Primary endpoint: Percentage of patients with SAEs; and Percentage of patients with treatment-emergent AESIs, ie, anemia.
Endpoint(s): Percentage of patients with clinically significant changes in heart rate and blood pressure., Percentage of patients with clinically significant changes in 12-lead ECG., Percentage of patients with clinically significant changes in physical examination., Percentage of patients with clinically significant changes in hematology, serum chemistry, urinalysis, and thyroid function., Percentage of patients with clinically significant changes in hearing audiometric testing (bone- and air-conduction)., The ratio of UPCR at 24 weeks compared to baseline; and Percentage of patients with a 25% reduction in UPCR at 24 weeks, compared to baseline., The ratio of eGFR at 24 weeks compared to baseline., Pre-dose and post-dose plasma concentrations of setanaxib and GKT138184 at steady state. The following PK properties will be calculated: Area under the concentration-time curve over 24 hours at steady state (AUC0-24-ss); Minimum plasma concentration at steady state (Cmin-ss); and Maximum plasma concentration at steady state (Cmax-ss).

Source: https://euclinicaltrials.eu/ctis-public/view/2023-505292-73-00